EU clinical trial 2024-519674-40-00: A Phase 1/2, Open-Label, Dose Finding Study to Investigate the Safety, Tolerability, and Efficacy of ALXN2350 Gene Therapy in Adult Participants with Symptomatic BAG3 Mutation-Associated Dilated Cardiomyopathy
Protocol code: ALXN2350-DCM-201
Sponsor: Alexion Pharmaceuticals Inc. (Pharmaceutical company). Phase: Phase I and Phase II (Integrated)- First administration to humans. Countries: Spain (ongoing, recruiting), Italy (ongoing, recruiting), Germany (not authorised).
Therapeutic area(s): Diseases [C] - Cardiovascular Diseases [C14]
Gender: Female, Male. Age: 18-64 years, 65+ years. Enrolment: 8.
Start date (EU): 2026-02-05. Decision date: 2025-10-16. Results received: No. Last updated: 2026-03-23.
Decision dates by country: DE: 2025-10-20, IT: 2025-10-16, ES: 2025-10-16

Condition(s): BAG3 Mutation Associated Dilated Cardiomyopathy
Product: Rapamune 1 mg/mL oral solution, Rapamune 0.5 mg coated tablets, Co-Trimoxazole Forte 160/800mg Tablets, Rapamune 2 mg coated tablets, adeno-associated virus, serotype 9 (AAV9), PREDNISONE VIATRIS 5 mg, comprimé sécable, PREDNISONE VIATRIS 1 mg, comprimé, PREDNISONE VIATRIS 20 mg, comprimé sécable, Prednisone Olikla 2.5 mg tablety, Prednisone Olikla 10 mg tablety, Prednisone Olikla 50 mg tablety, Rapamune 1 mg coated tablets

Primary endpoint: Part A : Incidence and severity of TEAEs and SAEs, and clinically significant safety findings (physical examinations, vital sign measurements, clinical laboratory assessments, and ECG results).
Endpoint(s): Part B : Incidence and severity of TEAEs and SAEs, and clinically significant safety findings (physical examinations, vital sign measurements, clinical laboratory assessments, and ECG results)., Part A and B : CFB in cardiac serum biomarker NT‑proBNP through Week 52 and 78., Part A and B : Incidence of cardiac events including heart failure hospitalization, sustained ventricular arrhythmias, appropriate implantable cardioverter defibrillator shock through Week 52 and 78., Part A and B : Time to the first event of death, heart transplant, mechanical circulating support, or aborted sudden cardiac death through Week 52 and 78., Part A and B : CFB of cardiac serum biomarker hs-TnT Week 52 and 78., Part A and B : Amount of virus secreted in blood, feces, saliva, semen, and urine through Week 52 and 78., Part A and B : Incidence of anti-AAV9 and anti BAG3 antibodies, response categories, and titer, in participants with BAG3-associated DCM treated with ALXN2350 through Week 52 and 78.

Source: https://euclinicaltrials.eu/ctis-public/view/2024-519674-40-00